EU clinical trial 2026-525434-33-00: Bioequivalence Study of Empagliflozin
Protocol code: 01-EMP-BIO-25
Sponsor: Tarchominskie Zaklady Farmaceutyczne Polfa S.A. (Pharmaceutical company). Phase: Human Pharmacology (Phase I)- Bioequivalence Study. Countries: Czechia (ended).
Therapeutic area(s): Diseases [C] - Nutritional and Metabolic Diseases [C18]; Diseases [C] - Cardiovascular Diseases [C14]
Gender: Female, Male. Age: 18-64 years. Enrolment: 32.
Status: Ended. Start date (EU): 2026-04-07. End date (EU): 2026-04-29. Decision date: 2026-03-11. Results received: No. Last updated: 2026-03-19.

Condition(s): Not applicable (submitted trial is a BE study in healthy participants)

Source: https://euclinicaltrials.eu/ctis-public/view/2026-525434-33-00